EU clinical trial 2023-504015-32-00: A Masked, Placebo-Controlled, Randomized, Pilot, Clinical Study of ApTOLL for the Treatment of Acute Ischemic Stroke at the Prehospital Level Using the RACE (Rapid Arterial oCclusion Evaluation) Scale
Protocol code: RACETOLL
Sponsor: Aptatargets S.L. (Pharmaceutical company). Phase: Therapeutic exploratory (Phase II). Countries: Spain (not authorised).
Therapeutic area(s): Diseases [C] - Nervous System Diseases [C10]
Gender: Female, Male. Age: 18-64 years, 65+ years. Enrolment: 180.
Status: Not authorised. Decision date: 2023-06-30. Results received: No. Last updated: 2023-06-30.

Condition(s): Acute Ischemic Stroke (AIS)
Product: ApTOLL, ApTOLL-Placebo

Primary endpoint: Enrolment of the desired sample size within the six-month enrolment window., Time to enrol the planned participants, Proportion of eligible patients that are enrolled., Time metrics related to pre-hospital workflows., Proportion of patients who are not tracked after enrolling (lost-to-follow-up or withdrawal of consent).
Endpoint(s): Rate of very poor outcome, as evaluated by a modified Rankin Scale (mRS) of 5 (very severe disability) or 6 (death) at 90 days, Mortality rate at 90 days., All serious adverse events (SAEs) that occur within the first 90 days following randomization. The frequency of SAEs will be reported overall, as well as by specific organ involvement., Early neurological worsening occurring after first hospital admission during the first seven days, as evaluated by an increase in the NIHSS score of 4 or more points, persisting for more than 24 hours, secondary to stroke progression, a symptomatic intracranial hemorrhage (Heidelberg criteria) the development of brain edema with midline shift associated with neurological worsening (malignant stroke), or hemorrhage expansion, as evaluated by the investigator., Final infarct volume at 72±24 hours on MRI-FLAIR (Magnetic Resonance Imaging - FLuid-Attenuated Inversion Recovery)., NIHSS (National institute of Health Stroke Scale) score at 72 hours assessed by investigators during hospitalization., Modified Rankin Scale at 90 days after randomization., Proinflammatory markers in blood between study groups in the following populations according in all patients with stroke (intracranial hemorrhage [ICH] and ischemic stroke).

Source: https://euclinicaltrials.eu/ctis-public/view/2023-504015-32-00